EU clinical trial 2025-521043-20-00: A Phase 2/3, multicenter, randomized open-label study of zanzalintinib vs everolimus in participants with previously treated, unresectable, locally advanced or metastatic neuroendocrine tumors
Protocol code: XL092-311
Sponsor: Exelixis Inc. (Pharmaceutical company). Phase: Phase II and Phase III (Integrated). Countries: France (ongoing, recruiting), Poland (ongoing, recruiting), Netherlands (authorised, recruiting), Belgium (authorised, recruiting), Germany (ongoing, recruiting), Spain (ongoing, recruiting), Italy (ongoing, recruiting), Austria (authorised, recruiting).
Therapeutic area(s): Diseases [C] - Neoplasms [C04]
Gender: Female, Male. Age: 18-64 years, 65+ years. Enrolment: 172.
Start date (EU): 2026-01-27. Decision date: 2026-01-09. Results received: No. Last updated: 2026-04-27.
Decision dates by country: DE: 2026-01-12, ES: 2026-01-14, PL: 2026-01-12, BE: 2026-01-09, NL: 2026-01-12, IT: 2026-01-12, AT: 2026-01-14, FR: 2026-01-14

Condition(s): Neuroendocrine tumors
Product: XL092, XL092, EVEROLIMUS, EVEROLIMUS, XL092

Primary endpoint: Progression-free survival per RECIST 1.1 as assessed by blinded independent central review
Endpoint(s): 1. Objective response rate per RECIST 1.1 as assessed by blinded independent central review, 2. Overall survival

Source: https://euclinicaltrials.eu/ctis-public/view/2025-521043-20-00